EU clinical trial 2023-507178-41-00: LIGHTBEAM-U01-Substudy 01A: A Phase 1/2 Substudy to Evaluate the Safety and Efficacy of Zilovertamab Vedotin in Pediatric and Young Adult Participants with Hematologic Malignancies or Solid Tumors.
Protocol code: MK-9999-01A
Sponsor: Merck Sharp & Dohme LLC (Pharmaceutical company). Phase: Phase I and Phase II (Integrated)- Other. Countries: Hungary (authorised, recruiting), Denmark (authorised, recruiting), Netherlands (authorised, recruiting), Czechia (authorised, recruiting), Sweden (authorised, recruiting), Italy (ongoing, recruiting), Greece (authorised, recruiting), Belgium (authorised, recruiting), France (authorised, recruiting), Spain (ongoing, recruiting), Germany (authorised, recruiting), Slovakia (authorised, recruiting).
Therapeutic area(s): Diseases [C] - Neoplasms [C04]
Gender: Female, Male. Age: 0-17 years, 18-64 years. Enrolment: 50.
Start date (EU): 2024-11-07. Decision date: 2024-04-15. Results received: No. Last updated: 2026-08-05.
Decision dates by country: HU: 2024-04-22, FR: 2024-04-22, GR: 2024-04-22, SK: 2025-03-31, DE: 2024-04-17, BE: 2024-04-22, NL: 2024-04-16, SE: 2024-04-19, ES: 2024-04-19, IT: 2024-04-19, DK: 2024-04-15, CZ: 2024-04-18

Condition(s): Hematologic Malignancies or Solid Tumors in Pediatric and Young Adults
Product: Zilovertamab vedotin

Primary endpoint: Part 1: Number of Participants from 1 to <18 years of Age Who Experience a Dose-Limiting Toxicity (DLT), Part 1: Number of Participants from 1 to <18 years of Age Who Experience One or More Adverse Events (AEs), Part 1: Number of Participants from 1 to <18 years of Age Who Discontinue Study Treatment Due to AEs, Part 1: Number of Participants from 1 to <18 years of Age Who Receive Dose Modification Due to AEs, Part 1 and Part 2: Objective Response (OR) for Participants with B-Cell Acute Lymphoblastic Leukemia (B-ALL), Part 1 and Part 2: OR for Participants with Diffuse Large B-Cell Lymphoma (DLBCL)/Burkitt Lymphoma, Neuroblastoma, and Ewing Sarcoma
Endpoint(s): Part 1 and Part 2: Area Under the Curve (AUC) of Total Antibody, Part 1 and Part 2: Maximum Plasma Concentration (Cmax) of Total Antibody, Part 1 and Part 2: Plasma Trough Concentration (Ctrough) of Total Antibody, Part 1 and Part 2: Apparent Terminal Half-life (t1/2) of Total Antibody, Part 1 and Part 2: AUC of Antibody-Drug Conjugate (ADC), Part 1 and Part 2: Cmax of Antibody-Drug Conjugate (ADC), Part 1 and Part 2: Ctrough of Antibody-Drug Conjugate (ADC), Part 1 and Part 2: t1/2 of Antibody-Drug Conjugate (ADC), Part 1 and Part 2: AUC of Monomethyl Auristatin E (MMAE), Part 1 and Part 2: Cmax of Monomethyl Auristatin E (MMAE), Part 1 and Part 2: Ctrough of Monomethyl Auristatin E (MMAE), Part 1 and Part 2: t1/2 of Monomethyl Auristatin E (MMAE), Part 2: Number of Participants Who Experience One or More Adverse Events (AEs), Part 2: Number of Participants Who Discontinue Study Treatment Due to AEs, Part 2: Number of Participants Who Receive Dose Modification Due to AEs, Part 1 and Part 2: Incidence of Antidrug antibodies (ADAs) to Zilovertamab Vedotin, Part 1 and Part 2: Duration of Response (DOR), Part 1 and Part 2: Percentage of Participants with DLBCL/Burkitt Lymphoma Who Receive Stem Cell Transplant (SCT), Part 1 and Part 2: Percentage of Participants with B-ALL Who Receive SCT, Part 1 and Part 2: Percentage of Participants with B-ALL Who Receive Chimeric Antigen Receptor T (CAR-T)

Source: https://euclinicaltrials.eu/ctis-public/view/2023-507178-41-00